EU clinical trial 2024-519063-18-00: A Global, Randomized, Open-label, Multicenter, Phase 2b/3 Trial Evaluating BJT-778 vs Delayed Treatment for the Treatment of Chronic Hepatitis Delta Infection (AZURE-1)
Protocol code: BJT-778-301
Sponsor: Mirum Pharmaceuticals Inc. (Pharmaceutical company). Phase: Phase II and Phase III (Integrated). Countries: Bulgaria (ongoing, recruitment ended).
Therapeutic area(s): Diseases [C] - Virus Diseases [C02]
Gender: Female, Male. Age: 18-64 years, 65+ years. Enrolment: 30.
Status: Ongoing, recruitment ended. Start date (EU): 2025-06-24. Decision date: 2025-06-17. Results received: No. Last updated: 2026-08-07.

Condition(s): Chronic Hepatitis Delta Infection
Product: BJT-778

Primary endpoint: The proportion of participants who achieve a composite endpoint of virologic response and ALT normalization. • Virologic response is defined as HDV RNA ≥2 log10 IU/mL decrease from Baseline or undetectable HDV RNA (< lower limit of quantification [LLOQ], target not detected [TND]),• ALT normalization is defined as a decrease in ALT from Baseline to ≤UNL. • The primary efficacy analysis will be tested according to the hierarchical testing.
Endpoint(s): The proportion of participants who achieve a composite endpoint of virologic response and ALT normalization. • Virologic response is defined as HDV RNA ≥2 log10 IU/mL decrease from Baseline or undetectable HDV RNA (< lower limit of quantification [LLOQ], target not detected [TND]),• ALT normalization is defined as a decrease in ALT from Baseline to ≤UNL. • The primary efficacy analysis will be tested according to the hierarchical testing., Safety endpoint will evaluate: • Incidence and severity of treatment-emergent adverse events (TEAE). • Proportion of participants who permanently discontinue treatment due to an adverse event., The proportion of participants who achieve the following during treatment: • Virologic response defined as ≥2 log10 IU/mL decline from baseline or undetectable HDV RNA • HDV RNA , The proportion of participants who achieve a composite endpoint at Weeks 24, 48, and 96., • Change from Baseline in liver stiffness as determined by transient elastography (e.g., FibroScan) at Weeks 24, 48, 96, 120 (Arm 3). • Change from Baseline in APRI at Weeks 24, 48, 96, 120 (Arm 3). • Change from Baseline in CTP score at Weeks 24, 48, 96, and 120 (Arm 3) in cirrhotic participants. • Change from Baseline in MELD score at Weeks 24, 48, 96, 120 (Arm 3) in cirrhotic participants., • Proportion of participants with clinical disease progression from Baseline in HDV-associated liver disease at Weeks 24, 48, 96, 120 (Arm 3). Progression will be determined by the IDMC., Proportion of participants who achieve HDV RNA

Source: https://euclinicaltrials.eu/ctis-public/view/2024-519063-18-00